EU clinical trial 2022-502360-21-00: "DEMETER": Milademetan and fulvestrant in GATA3-mutant, ER-positive, HER2-negative advanced or metastatic breast cancer patients: a multicenter phase II trial
Protocol code: IC 2022-05
Sponsor: Institut Curie (Hospital/Clinic/Other health care facility). Phase: Therapeutic exploratory (Phase II). Countries: France (ended).
Therapeutic area(s): Diseases [C] - Pathological Conditions, Signs and Symptoms [C23]
Gender: Female, Male. Age: 18-64 years, 65+ years. Enrolment: 48.
Status: Ended. Start date (EU): 2023-10-12. End date (EU): 2023-11-24. Decision date: 2023-06-06. Results received: Yes. Last updated: 2023-06-06.

Condition(s): GATA3-mutant, ER-positive, HER2-negative advanced or metastatic breast cancer
Product: Milademetan, Milademetan, Fulvestrant 250 mg solution for injection in pre-filled syringe, Milademetan, Milademetan, Milademetan, Milademetan

Primary endpoint: The proportion of patients who have achieved either a confirmed complete or partial response, or stable disease for at least 24 weeks after treatment start per RECIST 1.1 based on local investigator assessment
Endpoint(s): SAEs (serious adverse events) and AEs (adverse events) according to NCI CTCAE v5.0, by grade and their relationship to milademetan and/or fulvestrant., PFS (Progression-free survival), ORR (objective response rate), DoR (duration of response), OS (overall survival), The measure of interest is the mean difference in the change from baseline to different specific visits (each disease radiological assessment, disease progression and/or treatment discontinuation) in total/subscale scores of the 5 Dimension 5 Level (EQ-5D-5L) scale., Quantitative and qualitative analyses of ctDNA collected at baseline, during therapy and at tumor progression; GATA3 and MDM2 IHC on tumor tissue, Digital pathology analyses on tumor tissue.

Source: https://euclinicaltrials.eu/ctis-public/view/2022-502360-21-00